EU clinical trial 2023-509970-43-01: Tranexamic Acid for reduction of intra- and postoperative TRansfusion Requirements in elective Abdominal surgery: randomized controlled trial (TATRA)
Protocol code: KKSH-190
Sponsor: Martin-Luther-Universitaet Halle-Wittenberg (Educational Institution). Phase: Therapeutic use (Phase IV). Countries: Germany (ongoing, recruiting).
Therapeutic area(s): Analytical, Diagnostic and Therapeutic Techniques and Equipment [E] - Therapeutics [E02]
Gender: Female, Male. Age: 18-64 years, 65+ years. Enrolment: 850.
Status: Ongoing, recruiting. Start date (EU): 2024-06-17. Decision date: 2024-04-25. Results received: No. Last updated: 2026-08-03.

Condition(s): bleeding and transfusion requirements for major abdominal surgery, i.e., esophagectomy, gastrectomy, colectomy, rectal resection, pancreatic resection, and hepatectomy
Product: Isotone Kochsalz-Lösung 0,9 % Braun Infusionslösung, Tranexamsäure Carinopharm 100mg/ml Injektions-/Infusionslösung

Primary endpoint: Intra- or postoperative transfusion of at least one unit of Packed Red Blood Cells (PRBCs)
Endpoint(s): - Number of transfused Packed Red Blood Cells per patient - Estimated amount of intraoperative blood loss - Time to transfusion - Number and severity of postoperative in-hospital complications/mortality (max. 30 days) - Duration of hospital stay - Operation / Anaesthesia duration - D-dimer levels - Quality of life

Source: https://euclinicaltrials.eu/ctis-public/view/2023-509970-43-01